EU clinical trial 2023-509030-19-00: A study to assess the effect of single and repeated doses of JNJ-81241459 on a single dose of certain other drugs, when given together to healthy adult participants
Sponsor: Janssen Cilag International (Pharmaceutical company). Phase: Human Pharmacology (Phase I)- Other. Countries: Belgium (ended).
Therapeutic area(s): Diseases [C] - Immune System Diseases [C20]
Gender: Female, Male. Age: 18-64 years, 65+ years. Enrolment: 36.
Status: Ended. Start date (EU): 2024-03-18. End date (EU): 2024-06-21. Decision date: 2024-03-05. Results received: No. Last updated: 2024-03-05.

Condition(s): Plaque Psoriasis

Source: https://euclinicaltrials.eu/ctis-public/view/2023-509030-19-00